EU clinical trial 2023-509698-21-00: Phase III, Prospective, Multinational, Multicenter, Randomized, Controlled, Two-arm, Double Blind Study to Assess Efficacy and Safety of D-PLEX Administered Concomitantly with the Standard of Care (SoC), Compared to a SoC Treated Control Arm, in Prevention of Post Abdominal Surgery Incisional Infection.
Protocol code: D-PLEX 312
Sponsor: Polypid Ltd. (Pharmaceutical company). Phase: Therapeutic confirmatory (Phase III). Countries: Ireland (ended), Poland (ended), Portugal (ended), Hungary (ended), Germany (ended), Italy (ended), Romania (ended).
Therapeutic area(s): Diseases [C] - Bacterial Infections and Mycoses [C01]
Gender: Female, Male. Age: 18-64 years, 65+ years. Enrolment: 474.
Status: Ended. Start date (EU): 2021-03-17. End date (EU): 2025-05-08. End date: 2025-05-10. Decision date: 2024-02-05. Results received: Yes. Last updated: 2025-02-24.
Decision dates by country: DE: 2024-06-13, IE: 2024-06-12, IT: 2024-06-11, PT: 2024-02-05, PL: 2024-02-13, HU: 2024-02-05, RO: 2024-08-12

Condition(s): Prevention of post abdominal surgery incisional infection.
Product: D-PLEX

Primary endpoint: Infection rate as measured by the proportion of subjects with at least one abdominal target incisional infection event, occurring within 30 days post abdominal surgery and determined by a blinded and independent adjudication committee, in the study population with longer incision (>20cm). [abdominal incisional infection is defined as Deep Incisional Surgical Site Infection (DSSI) and/or Superficial Incisional Surgical Site Infection (SSSI)].
Endpoint(s): Infection rate as measured by the proportion of subjects with at least one abdominal target incisional infection event, occurring within 30 days post abdominal (index) surgery and determined by a blinded and independent adjudication committee, in the population of subjects with target incision length >20cm., Infection rate as measured by the proportion of subjects with at least one abdominal target incisional infection event, occurring within 30 days post abdominal surgery and determined by a blinded and independent adjudication committee, in the overall study population (incision ≥7cm). All-cause mortality and re-interventions through the abdominal incision (target) within 30 days post index surgery will be analysed as treatment failure., Number (percent) of subjects with at least 1 score of ASEPSIS > 20, within 30 days post abdominal (index) surgery (population of subjects with target incision length >20cm)., Additional endpoints (population of subjects with target incision length >20cm): Incidence of SSSI during 30 days post index surgery., Additional endpoints (population of subjects with target incision length >20cm): Incidence of DSSI during 30 days post index surgery., Additional endpoints (population of subjects with target incision length >20cm): All-cause mortality rate within 30 days post randomization., Additional endpoints (population of subjects with target incision length >20cm): All-cause mortality rate within 60 days post randomization., Additional endpoints (population of subjects with target incision length >20cm): Time to adjudicated SSI during 30 days post index surgery., Additional endpoints (population of subjects with target incision length >20cm): Number (percent) of subjects re-admitted during 30 days post index surgery (for any reason) that have experienced adjudicated SSI during this re-admission., Additional endpoints (population of subjects with target incision length >20cm): Number (percent) of subjects who experienced at least 1 surgical re-intervention due to adjudicated SSIs during 30 days post index surgery., SSI related Additional Endpoints: Number (percent) of subjects with adjudicated SSI where at least one Doxycycline-resistant bacteria have grown in bacteriology tests., SSI related Additional Endpoints: Number (percent) of Doxycycline-resistant bacteria out of all bacteria that were cultured during bacteriology test from subjects with adjudicated SSI., SSI related Additional Endpoints: Number (percent) of subjects who experienced adjudicated SSI during 30 days post index surgery that were treated by IV antibiotic., SSI related Additional Endpoints: Number of IV antibiotic treatment days, administered to subjects who experience adjudicated SSI during 30 days post index surgery., SSI related Additional Endpoints: Average of subjects’ cumulative ASEPSIS assessment score (AUC) for subjects with adjudicated SSI during 30 days., SSI related Additional Endpoints: Number (percent) of subjects with at least 1 score of ASEPSIS > 20 in subject with adjudicated SSI within 30 days post abdominal (index) surgery.

Source: https://euclinicaltrials.eu/ctis-public/view/2023-509698-21-00